EU clinical trial 2024-514168-15-00: Tolerability of concurrent EBRT + Lu-PSMA for node-positive prostate cancer (PROQURE-1)
Sponsor: Het Nederlands Kanker Instituut-Antoni van Leeuwenhoek Ziekenhuis Stichting (Hospital/Clinic/Other health care facility). Phase: Human Pharmacology (Phase I)- Other. Countries: Netherlands (ended).
Therapeutic area(s): Diseases [C] - Neoplasms [C04]
Gender: Male. Age: 18-64 years, 65+ years. Enrolment: 24.
Status: Ended. Start date (EU): 2021-12-17. End date (EU): 2025-09-09. Decision date: 2024-05-23. Results received: No. Last updated: 2024-05-23.

Condition(s): N+M0 prostate cancer

Source: https://euclinicaltrials.eu/ctis-public/view/2024-514168-15-00